EU clinical trial 2024-512144-39-00: Long-term efficacy and safety of cagrilintide s.c. 2.4 mg in combination with semaglutide s.c. 2.4 mg (CagriSema 2.4 mg/2.4 mg) once weekly versus placebo in participants with obesity
Protocol code: NN9838-7859
Sponsor: Novo Nordisk A/S (Pharmaceutical company). Phase: Therapeutic confirmatory (Phase III). Countries: Denmark (ongoing, recruitment ended), Belgium (ongoing, recruitment ended), Portugal (ongoing, recruitment ended).
Therapeutic area(s): Diseases [C] - Nutritional and Metabolic Diseases [C18]
Gender: Female, Male. Age: 18-64 years, 65+ years. Enrolment: 160.
Status: Ongoing, recruitment ended. Start date (EU): 2025-01-22. Decision date: 2025-01-16. Results received: No. Last updated: 2026-05-05.
Decision dates by country: PT: 2025-01-20, DK: 2025-01-18, BE: 2025-01-16

Condition(s): Obesity
Product: Placebo + Placebo, cagrilintide semaglutide, cagrilintide semaglutide, cagrilintide semaglutide, cagrilintide semaglutide, cagrilintide semaglutide

Primary endpoint: Relative change in body weight
Endpoint(s): Achievement of ≥ 20% body weight reduction (yes/no), Achievement of ≥ 25% body weight reduction (yes/no), Achievement of ≥ 30% body weight reduction (yes/no), Change in waist circumference, Change in waist to height ratio, Change in SBP, Ratio to baseline in: • Total cholesterol • High density lipoprotein (HDL) cholesterol • Low density lipoprotein (LDL) cholesterol • Very low-density lipoprotein (VLDL) cholesterol • Triglycerides • Free fatty acids • Non-HDL cholesterol, Change in BMI, Achievement of BMI < 30 kg/m2, Change in glycated haemoglobin (HbA1c), Change in Fasting Plasma Glucose (FPG), Achievement of HbA1c < 5.7% and FPG < 100 mg/dL with prediabetes at baseline, Time to HbA1c < 5.7% and FPG < 100 mg/dL with prediabetes at baseline, Development of HbA1c ≥ 5.7% or FPG > 100 mg/dL with normoglycemia at baseline, Development of T2D as per ADA guideline, Time to T2D diagnosis as per ADA guideline, Change in ACC/AHA 10-year ASCVD risk score, Improvement in ≥ 1 pre existing cardiometabolic ORC (hypertension, prediabetes, or dyslipidaemia), Ratio to baseline in C-reactive protein (CRP), Change in total fat mass by dual energy X-ray absorption (DXA) absolute and relative to total body mass, Change in visceral fat mass by DXA, relative to baseline and relative to total amount of fat mass in visceral fat mass region, Change in lean body mass by DXA absolute and relative to total body mass, Change in SF-36 Physical functioning score, Change in IWQOL-Lite-CT: • Physical function score • Physical score • Psychosocial score • Total score, Change in Impact of Weight on Daily Activities Questionnaire (IWDAQ) Composite score, Change in Control of Eating questionnaire (CoEQ): • Craving Control score • Positive Mood score • Craving for Sweets score • Craving for Savoury score • Hunger score • Satiety score, Number of Treatment Emergent Adverse Events (TEAEs), Number of Treatment Emergent Serious Adverse Events (TESAEs), Achievement of HbA1c ≥ 6.5% or FPG ≥ 126 mg/dL with prediabetes at baseline, Time to HbA1c ≥ 6.5% or FPG ≥ 126 mg/dL with prediabetes at baseline

Source: https://euclinicaltrials.eu/ctis-public/view/2024-512144-39-00